EU clinical trial 2024-513292-40-00: DESIRE MS: A prospective randomized non-inferiority trial comparing anti-CD20 maintenance versus De-Escalation Strategy In Relapsing-Remitting Multiple Sclerosis
Protocol code: RECHMPL23_0397
Sponsor: Centre Hospitalier Universitaire De Montpellier (Hospital/Clinic/Other health care facility). Phase: Therapeutic confirmatory (Phase III). Countries: France (ongoing, recruiting).
Therapeutic area(s): Diseases [C] - Nervous System Diseases [C10]
Gender: Female, Male. Age: 18-64 years, 65+ years. Enrolment: 250.
Status: Ongoing, recruiting. Start date (EU): 2026-06-15. Decision date: 2025-04-28. Results received: No. Last updated: 2025-04-28.

Condition(s): Multiple sclerosis
Product: OFATUMUMAB, DIMETHYL FUMARATE, OCRELIZUMAB, PEGINTERFERON BETA-1A, DIMETHYL FUMARATE, GLATIRAMER ACETATE, TERIFLUNOMIDE, GLATIRAMER ACETATE, DIROXIMEL FUMARATE, INTERFERON BETA-1A, RITUXIMAB, INTERFERON BETA-1A

Primary endpoint: The % of patients without disease activity between D0 and M36. Disease activity is defined as 1) the presence of at least one clinical relapse between inclusion and M36 AND/OR 2) Brain MRI activity defined as at least 1 new/enlarged T2/FLAIR lesion on MRI scans between baseline MRI and M36.
Endpoint(s): Relapses, Disability, New/enlarged T2/FLAIR lesions, Adverse event and severe adverse events, Infections and serious infections, B-cells counts, Serum immunoglobulin levels (IgG, A, M), Brain volume, Neurofilaments light chain values, EQ5D-5L score, MUSICARE score, Incremental cost-utility ratio at year 3, Annual budget impact from the SNDS (Système National des Données de Santé hosted by French Health Insurance)

Source: https://euclinicaltrials.eu/ctis-public/view/2024-513292-40-00